EU clinical trial 2023-506207-26-00: The Colchicine heart failure preserved trial
Sponsor: Gentofte Hospital (Hospital/Clinic/Other health care facility). Phase: Therapeutic confirmatory (Phase III). Countries: Denmark (ongoing, recruiting).
Therapeutic area(s): Diseases [C] - Cardiovascular Diseases [C14]
Gender: Female, Male. Age: 18-64 years, 65+ years. Enrolment: 152.
Status: Ongoing, recruiting. Start date (EU): 2024-01-18. Decision date: 2023-09-27. Results received: No. Last updated: 2026-06-11.

Condition(s): Heart failure with preserved ejection fraction (HFpEF)
Product: Placebo will be identical in appearance and contain the following ingredients: lactosemonohydrate, potato starch, spiritus gelatinae 5%, magnesium stearate, talcum., Colrefuz 500 mikrogram tabletter

Primary endpoint: To investigate the effect of colchicine, as compared with placebo, on heart failure related health status using the Kansas City Cardiomyopathy Questionnaire Clinical Summary Score (KCCQ-CS)
Endpoint(s): To investigate the effect of colchicine, as compared to placebo, on heart failure related health status using the Kansas City Cardiomyopathy Questionnaire Overall Summary Score (KCCQ-OS)., To investigate the effect of colchicine on the proportion of patients with a ≥ 5-point increase in KCCQ-CS and KCCQ-OS compared to placebo

Source: https://euclinicaltrials.eu/ctis-public/view/2023-506207-26-00